EU clinical trial 2025-525121-13-00: Randomized Evaluation of fleCAinide safety vs. STandard of care in patients with coronary artery disease and Atrial Fibrillation (ReCAST AF).
Protocol code: S69367
Sponsor: UZ Leuven (Hospital/Clinic/Other health care facility). Phase: Therapeutic use (Phase IV). Countries: Belgium (authorised, recruitment pending).
Therapeutic area(s): Diseases [C] - Cardiovascular Diseases [C14]
Gender: Female, Male. Age: 18-64 years, 65+ years. Enrolment: 988.
Status: Authorised, recruitment pending. Decision date: 2026-06-26. Results received: No. Last updated: 2026-06-26.

Condition(s): Coronary artery disease, Atrial fibrillation
Product: Amiodarone EG 200 mg tabletten, Flecainide Retard EG 150 mg harde capsules met verlengde afgifte, Flecainide Retard EG 100 mg harde capsules met verlengde afgifte, Sotalol Sandoz 80 mg tabletten, Flecainide Retard EG 200 mg harde capsules met verlengde afgifte, Sotalol Sandoz 160 mg tabletten

Primary endpoint: A composite safety outcome including the following adverse events of interest: (1) All-cause mortality; (2) Severe adverse events leading to drug discontinuation; and (3) Unscheduled hospitalisation for heart failure or acute coronary syndrome
Endpoint(s): Individual components of the primary safety endpoint, Freedom from fast atrial arrhythmia post-treatment (clinical recurrence of AF), Major adverse cardiovascular events (MACE): cardiovascular mortality, non-fatal myocardial infarction, non-fatal stroke, Incidence of catheter ablation for AF during follow-up, Total number of days of cardiovascular hospitalisation, All adverse and serious adverse events (frequency and severity, proportion of participants experiencing at least one AE/SAE, specific drug-related adverse events), Changes in cardiac function from baseline to follow-up (left ventricular ejection fraction, global longitudinal strain, left atrial volume index), Change in N-terminal-pro-brain Natriuretic Peptide (NT-proBNP) from baseline, Change in QTc interval (ms) and QRS duration (ms) from baseline., Patient-reported outcome measures, including: Atrial Fibrillation Effect on Quality of Life (AFEQT) questionnaire; EuroQoL-5 dimension health utility index (EQ-5D-5L); Short Form-12 (SF-12) health survey; EHRA symptom score; Work Productivity and Activity Impairment (WPAI) questionnaire, Economic evaluation with within-trial healthcare resource utilization between the two treatment arms

Source: https://euclinicaltrials.eu/ctis-public/view/2025-525121-13-00